EU clinical trial 2023-505928-59-00: A Phase III, Open-label, Randomised Study of Neoadjuvant Datopotamab Deruxtecan (Dato-DXd) Plus Durvalumab Followed by Adjuvant Durvalumab With or Without Chemotherapy Versus Neoadjuvant Pembrolizumab Plus Chemotherapy Followed by Adjuvant Pembrolizumab With or Without Chemotherapy for the Treatment of Adult Patients with Previously Untreated Triple-Negative or Hormone Receptor-low/HER2-negative Breast Cancer (D926QC00001; TROPION-Breast04)
Protocol code: D926QC00001
Sponsor: Astrazeneca AB (Pharmaceutical company). Phase: Therapeutic confirmatory (Phase III). Countries: Bulgaria (ongoing, recruitment ended), Austria (ongoing, recruitment ended), Poland (ongoing, recruitment ended), Germany (ongoing, recruitment ended), Hungary (ongoing, recruitment ended), Spain (ongoing, recruitment ended), France (ongoing, recruitment ended), Italy (ongoing, recruitment ended), Belgium (ongoing, recruitment ended).
Therapeutic area(s): Diseases [C] - Neoplasms [C04]
Gender: Female, Male. Age: 18-64 years, 65+ years. Enrolment: 501.
Status: Ongoing, recruitment ended. Start date (EU): 2024-04-15. Decision date: 2024-03-12. Results received: No. Last updated: 2026-04-23.
Decision dates by country: ES: 2024-03-12, PL: 2024-03-20, AT: 2024-03-25, FR: 2024-03-13, HU: 2024-03-18, BG: 2024-03-25, IT: 2024-03-14, BE: 2024-03-19, DE: 2024-03-13

Condition(s): Triple Negative or Hormone Receptor low/HER2-negative Breast Cancer
Product: CYCLOPHOSPHAMIDE, PACLITAXEL, MYCOPHENOLATE MOFETIL, CYCLOPHOSPHAMIDE, CYCLOPHOSPHAMIDE, CAPECITABINE, EPIRUBICIN, IMFINZI 50 mg/mL concentrate for solution for infusion., CAPECITABINE, CARBOPLATIN, INFLIXIMAB, MYCOPHENOLATE MOFETIL, MYCOPHENOLATE MOFETIL, CYCLOPHOSPHAMIDE, PEMBROLIZUMAB, Datopotamab deruxtecan, Lynparza 150 mg film-coated tablets, Lynparza 100 mg film-coated tablets, MYCOPHENOLATE MOFETIL, DOXORUBICIN

Primary endpoint: Endpoint Event free survival (EFS) is defined as the time from the date of randomisation until the date of the first occurrence of any of the following events: disease progression precluding surgery, disease recurrence (local, regional, distant, or contralateral), second primary invasive cancer (other than squamous or basal cell skin cancer), or relapse from prior malignancy, or death by any cause (in the absence of recurrence).
Endpoint(s): Key Secondary: pathological complete response (pCR) rate is defined as the proportion of participants who have no evidence by haematoxylin and eosin staining of residual invasive disease or lymphovascular invasion at the time of definitive surgery in the complete resected breast specimen and all sampled regional lymph nodes (ypT0/Tis ypN0) by blinded central evaluation following completion of neoadjuvant systemic therapy per AJCC staging criteria (edition 8)., Key secondary- overall survival (OS) is defined as the time from the date of randomisation until the date of death due to any cause., Distant disease-free survival (DDFS) is defined as the time from the date of randomisation until the date of the first occurrence of any of the following events: distant metastasis, occurrence of second primary invasive cancer (other than squamous or basal cell skin cancer), relapse from prior malignancy or death by any cause (in the absence of recurrence).

Source: https://euclinicaltrials.eu/ctis-public/view/2023-505928-59-00